EU clinical trial 2023-505169-10-00: A PHASE 2 MULTICENTER STUDY OF AXICABTAGENE CILOLEUCEL IN SUBJECTS WITH RELAPSED/REFRACTORY INDOLENT NON-HODGKIN LYMPHOMA (INHL)
Protocol code: KTE-C19-105
Sponsor: Kite Pharma Inc. (Pharmaceutical company). Phase: Therapeutic exploratory (Phase II). Countries: France (ended).
Therapeutic area(s): Diseases [C] - Neoplasms [C04]
Gender: Female, Male. Age: 18-64 years. Enrolment: 10.
Status: Ended. Start date (EU): 2018-09-07. End date (EU): 2024-10-03. End date: 2024-12-05. Decision date: 2023-09-26. Results received: Yes. Last updated: 2024-04-08.

Condition(s): Follicular Lymphoma, Marginal Zone Lymphoma, Indolent Non-Hodgkin Lymphoma
Product: TOCILIZUMAB, DEXAMETHASONE, FLUDARABINE, METHYLPREDNISOLONE, CYCLOPHOSPHAMIDE, DIPHENHYDRAMINE, MESNA, YESCARTA 0.4 – 2 x 10e8 cells dispersion for infusion, PARACETAMOL

Primary endpoint: Objective response rate (ORR) per central read for up to 15 years
Endpoint(s): CR Rate per central read for up to 15 years., DOR for up to 15 years., PFS for up to 15 years., Percentage of Participants Experiencing Treatment-Emergent Adverse Events for up to 15 years., Levels of anti-CD19 CAR T cells in blood at enrollment, Day 7, Week 2, Week 4, Month 3, Month 6, Month 12, Month 18, Month 24, annually up to year 5., Levels of cytokines in serum at enrollment, prior to axicabtagene ciloleucel infusion on Day 0, Day 3, Day 7, Week 2, Week 4., Percentage of Participants experiencing anti-axicabtagene ciloleucel antibodies at Week 4, Month 3, every 3 months up to Month 12., Percentage of Participants Experiencing clinically significant changes in lab values for up to 15 years, Time to next therapy for up to 15 years., Objective response rate among participants with 3 or more lines of prior therapy for up to 15 years., Complete response rate among those participants with 3 or more lines of prior therapy for up to 15 years., Objective Response Rate as Determined by the Investigator Read for up to 15 years., Best Objective Response per Central Read or Investigator Read for up to 15 years., Overall survival for up to 15 years

Source: https://euclinicaltrials.eu/ctis-public/view/2023-505169-10-00